EU clinical trial 2024-516252-17-00: A randomised, open-label, parallel group study to compare the pharmacokinetics and pharmacodynamics of NEODIDRO® 0.266 mg vs DIBASE® 25,000 IU oral doses in male and female patients.
Protocol code: CRC2024_01
Sponsor: Centro Ricerche Cliniche Di Verona S.r.l. (Laboratory/Research/Testing facility). Phase: Human Pharmacology (Phase I)- Other. Countries: Italy (ongoing, recruiting).
Therapeutic area(s): Diseases [C] - Nutritional and Metabolic Diseases [C18]
Gender: Female, Male. Age: 18-64 years. Enrolment: 48.
Status: Ongoing, recruiting. Start date (EU): 2025-12-09. Decision date: 2024-12-02. Results received: No. Last updated: 2025-12-22.

Condition(s): Patients with low Vitamin D plasma level

Source: https://euclinicaltrials.eu/ctis-public/view/2024-516252-17-00